EU clinical trial 2024-515439-31-00: B7981028 - A LONG-TERM, DOUBLE-BLIND EXTENSION STUDY TO INVESTIGATE THE SAFETY AND EFFICACY OF RITLECITINIB IN PARTICIPANTS WITH SEVERE ALOPECIA AREATA WHO PREVIOUSLY COMPLETED STUDIES B7981027 OR B7981031
Protocol code: B7981028
Sponsor: Pfizer Inc. (Pharmaceutical company). Phase: Therapeutic confirmatory (Phase III). Countries: Italy (authorised, recruitment pending), France (authorised, recruitment pending), Czechia (authorised, recruitment pending), Poland (authorised, recruitment pending), Spain (authorised, recruitment pending).
Therapeutic area(s): Diseases [C] - Immune System Diseases [C20]
Gender: Female, Male. Age: 0-17 years. Enrolment: 78.
Status: Authorised, recruitment pending. Decision date: 2025-10-14. Results received: No. Last updated: 2026-04-30.
Decision dates by country: PL: 2025-10-17, FR: 2025-10-14, CZ: 2025-10-15, ES: 2025-10-15, IT: 2025-10-14

Condition(s): Alopecia areata
Product: Placebo to match ritlecitinib 50 mg, Ritlecitinib tosilate, Ritlecitinib, Placebo to match ritlecitinib 30 mg

Primary endpoint: • Incidence of treatment-emergent adverse events (AEs). • Incidence of serious AEs (SAEs) and AEs leading to permanent discontinuation from the study.
Endpoint(s): • Response based on achieving absolute Severity of Alopecia Tool (SALT) score ≤10 at all visits. • Response based on achieving absolute SALT score ≤20 at all visits • Change from baseline (CFB) in SALT score at all visits. • Response based on achieving at least 2 grade improvement or a score of 3 in eyebrow assessment (EBA) score at all visits in participants with an abnormal EBA at baseline., • Response based on achieving at least 2 grade improvement or a score of 3 in eyelash assessment (ELA) score at all visits in participants with an abnormal ELA at baseline. • Patient Global Impression of Change (PGI-C) response defined as score of “moderately improved or greatly improved” at all time points., • CFB in Patient Reported Outcomes Measurement Information System (PROMIS) Parent Proxy Depressive Symptoms T-score at all visits. • CFB in PROMIS Parent Proxy Anxiety Symptoms T-score at all visits., • CFB in Behavior Rating Inventory of Executive Function®2 (BRIEF®2) T-scores for the three index scores (Behavior Regulation Index [BRI], Emotional Regulation Index [ERI], Cognitive Regulation Index [CRI]) at all visits., • CFB in modified Children's Dermatology Life Quality Index (CDLQI) total score at all visits. • CFB# in Wechsler Intelligence Scale for Children® Fifth Edition (WISC-V) at end of study (Month 36).

Source: https://euclinicaltrials.eu/ctis-public/view/2024-515439-31-00